EU clinical trial 2023-504270-38-00: A Randomized, Double-Blind, Multicenter, Phase 2 Study of Retifanlimab in Combination With INCAGN02385 (Anti–LAG-3) and INCAGN02390 (Anti–TIM-3) as First-Line Treatment in Participants With PD-L1–Positive (CPS ≥ 1) Recurrent/Metastatic Squamous Cell Carcinoma of the Head and Neck
Protocol code: INCAGN 2385-203
Sponsor: Incyte Biosciences International S.a.r.l. (Pharmaceutical company). Phase: Therapeutic exploratory (Phase II). Countries: Italy (ended), Greece (ended), Portugal (ended), France (ended), Spain (ended).
Therapeutic area(s): Diseases [C] - Neoplasms [C04]
Gender: Female, Male. Age: 18-64 years, 65+ years. Enrolment: 66.
Status: Ended. Start date (EU): 2022-10-18. End date (EU): 2026-05-27. End date: 2026-06-24. Decision date: 2024-10-22. Results received: No. Last updated: 2026-01-14.
Decision dates by country: GR: 2024-10-22, PT: 2024-10-22, IT: 2024-10-28, FR: 2024-10-25, ES: 2024-10-23

Condition(s): In participants with PD-L1–positive and systemic therapy–naive R/M SCCHN.
Product: INCAGN02385, Retifanlimab (INCMGA00012), INCAGN02390

Primary endpoint: PFS, defined as the interval between the date of randomization and the earliest date of disease progression, based on investigator assessment per RECIST v1.1, or death due to any cause.
Endpoint(s): • Objective response, defined as having a CR or PR, determined based on investigator assessment per RECIST v1.1. • DOR, defined as the time from earliest date of disease response (CR or PR) until earliest date of disease progression, based on investigator assessment per RECIST v1.1, or death from any cause if occurring sooner than progression. • Disease control, defined as having CR, PR, or SD (≥ 6 months) as best response, based on investigator assessment per RECIST v1.1., OS, defined as the interval between the date of randomization until death due to any cause., • AEs, assessed in body systems with symptoms, through physical examinations, changes in vital signs and ECGs, and through clinical laboratory blood sample evaluations. • Impact on-study treatment, assessed by treatment interruptions, dose delays, and withdrawal of study treatment due to AEs.

Source: https://euclinicaltrials.eu/ctis-public/view/2023-504270-38-00